EU clinical trial 2024-516662-11-00: ATHENA (A Multicenter, Randomized, Double-Blind, Placebo-Controlled Phase 3 Study in Ovarian Cancer Patients Evaluating Rucaparib and Nivolumab as Maintenance Treatment Following Response to Front-Line Platinum-Based Chemotherapy)
Protocol code: CO-338-087
Sponsor: pharmaand GmbH (Pharmaceutical company). Phase: Therapeutic confirmatory (Phase III). Countries: Italy (ended), Romania (ended), Denmark (ended), Czechia (ended), Germany (ended), Poland (ended), Belgium (ended), Sweden (ended), Spain (ended), Greece (ended), Ireland (ended).
Therapeutic area(s): Diseases [C] - Neoplasms [C04]
Gender: Female. Age: 18-64 years, 65+ years. Enrolment: 257.
Status: Ended. Start date (EU): 2018-11-23. End date (EU): 2026-06-23. End date: 2026-07-16. Decision date: 2024-11-13. Results received: No. Last updated: 2026-05-11.
Decision dates by country: DK: 2024-11-13, PL: 2024-11-14, BE: 2024-11-13, RO: 2024-11-19, IE: 2024-11-13, GR: 2024-12-09, CZ: 2024-11-13, DE: 2024-11-15, SE: 2024-11-15, IT: 2024-11-25, ES: 2024-11-13

Condition(s): Ovarian epithelial cancer, Malignant peritoneal neoplasm, advanced (FIGO stage III-IV), high-grade epithelial ovarian, fallopian tube, or primary peritoneal cancer (who responded to front-line platinum-based chemotherapy), Fallopian tube cancer
Product: Placebo for Opdivo, Rubraca 200 mg film-coated tablets, Rubraca 250 mg film-coated tablets, Rubraca 300 mg film-coated tablets, OPDIVO 10 mg/mL concentrate for solution for infusion., Placebo for Rubraca

Primary endpoint: The primary efficacy endpoint for the study is investigator-determined progression-free survival (PFS) by RECIST v1.1. Investigator-determined PFS is defined as the time from randomization to disease progression, according to RECIST v1.1 criteria as assessed by the investigator, or death due to any cause, whichever occurs first.
Endpoint(s): Secondary Efficacy Endpoints: Progression-free survival (PFS) as assessed by blinded independent central review (BICR) by RECIST will be tested as a stand-alone secondary endpoint, outside of the step-down procedure for multiplicity adjustment, due to it being supportive of the primary endpoint., BicrPFS is defined as the time from randomization to disease progression, according to RECIST v1.1 criteria as assessed by BICR, or death due to any cause, whichever occurs first. Only tumor scans prior to start of any subsequent anti-cancer treatment are included. Overall survival is defined as the time from randomization to death due to any cause., Analyses of objective response rate (ORR) will be performed in the subgroup of patients with measurable disease at baseline and will be summarized with frequencies and percentages. Duration of response (DOR) will be tested as a stand-alone secondary endpoint, outside of the step-down procedure for multiplicity adjustment., DOR is defined as the interval from the first documentation of objective response (RECIST v1.1) to the earlier of the first documentation of disease progression (per RECIST v1.1) or death from any cause. Safety Analysis: Adverse events, clinical laboratory results, vital signs, ECOG performance status, body weight, and concomitant medications/procedures.

Source: https://euclinicaltrials.eu/ctis-public/view/2024-516662-11-00